EU clinical trial 2024-518144-20-00: A Phase 1/2 Dose Escalation Study to Evaluate the Safety, Tolerability, Pharmacokinetics, Pharmacodynamics and Preliminary Efficacy of ABO-101 in Participants with Primary Hyperoxaluria Type 1 (PH1)
Protocol code: ABO-101-101
Sponsor: Arbor Biotechnologies Inc. (Pharmaceutical company). Phase: Phase I and Phase II (Integrated)- First administration to humans. Countries: Germany (authorised, recruitment pending), France (authorised, recruiting), Netherlands (authorised, recruitment pending).
Therapeutic area(s): Diseases [C] - Congenital, Hereditary, and Neonatal Diseases and Abnormalities [C16]; Diseases [C] - Nutritional and Metabolic Diseases [C18]
Gender: Female, Male. Age: 0-17 years, 18-64 years. Enrolment: 6.
Start date (EU): 2025-09-03. Decision date: 2025-05-15. Results received: No. Last updated: 2026-01-26.
Decision dates by country: NL: 2025-06-05, DE: 2025-07-07, FR: 2025-05-19

Condition(s): Primary Hyperoxaluria Type 1 (PH1)
Product: ABO-101

Primary endpoint: Incidence and severity of treatment-emergent adverse events (TEAEs), including ABO-101- related TEAEs and serious adverse events (SAEs)
Endpoint(s): Percent change in 24-hour urinary oxalate excretion (UOx) from Baseline to Month (CCI), Absolute change in UOx corrected for body surface area, Percent change in plasma glycolate from Baseline to Month (CCI), Changes in estimated glomerular filtration rate (eGFR) from Baseline to Month (CCI) and Month (CCI), Plasma concentrations for (CCI), and (CCI), Urine concentrations for (CCI) and (CCI), Antidrug antibodies to ABO-101 and anti-Cas12i2 protein antibodies

Source: https://euclinicaltrials.eu/ctis-public/view/2024-518144-20-00